EU clinical trial 2022-501425-20-00: J1A-MC-KDAF: A Phase 2b, Double-Blind, Placebo-Controlled Study to Evaluate Peresolimab in Adult Participants with Moderately-to-Severely Active Rheumatoid Arthritis
Sponsor: Eli Lilly & Co. (Pharmaceutical company). Phase: Therapeutic exploratory (Phase II). Countries: Hungary (ended), Spain (ended), Italy (not authorised), Poland (ended), Greece (ended).
Therapeutic area(s): Diseases [C] - Immune System Diseases [C20]
Gender: Female, Male. Age: 18-64 years, 65+ years. Enrolment: 69.
Status: Ended. Start date (EU): 2023-04-03. End date (EU): 2024-09-16. End date: 2025-01-17. Decision date: 2023-02-27. Results received: Yes. Last updated: 2024-05-14.
Decision dates by country: IT: 2023-03-03, HU: 2023-03-03, ES: 2023-02-27, PL: 2023-03-06, GR: 2023-02-28

Condition(s): Rheumatoid Arthritis; Arthritis; Joint Diseases; Musculoskeletal Diseases; Rheumatic Diseases; Connective Tissue Diseases; Autoimmune Diseases; Immune System Diseases
Product: SODIUM CHLORIDE

Primary endpoint: Percentage of Participants Achieving American College of Rheumatology (ACR)20 ACR20 – 20% improvement in the ACR core set values

Source: https://euclinicaltrials.eu/ctis-public/view/2022-501425-20-00